EU clinical trial 2025-521916-20-00: A Study of LY4175408 in Participants With Advanced or Metastatic Solid Tumors.
Protocol code: J6D-MC-JSDA
Sponsor: Eli Lilly & Co. (Pharmaceutical company). Phase: Human Pharmacology (Phase I)- First administration to humans. Countries: Spain (ongoing, recruiting), France (ongoing, recruiting).
Therapeutic area(s): Diseases [C] - Neoplasms [C04]
Gender: Female, Male. Age: 18-64 years, 65+ years. Enrolment: 100.
Status: Ongoing, recruiting. Start date (EU): 2025-10-24. Decision date: 2025-09-29. Results received: No. Last updated: 2026-07-16.
Decision dates by country: FR: 2025-09-29, ES: 2025-10-01

Condition(s): Cancer

Source: https://euclinicaltrials.eu/ctis-public/view/2025-521916-20-00